EU clinical trial 2025-522987-34-00: A Phase 2, Long-term Extension Study of the Safety and Efficacy of ORX750 in Participants with Narcolepsy and Idiopathic Hypersomnia Who Completed a Sponsored ORX750 Clinical Trial
Protocol code: ORX750-202
Sponsor: Centessa Pharmaceuticals UK Limited (Pharmaceutical company). Phase: Therapeutic exploratory (Phase II). Countries: France (authorised, recruitment pending), Spain (ongoing, recruiting), Italy (ongoing, recruiting).
Therapeutic area(s): Diseases [C] - Nervous System Diseases [C10]
Gender: Female, Male. Age: 18-64 years, 65+ years. Enrolment: 55.
Start date (EU): 2026-03-13. Decision date: 2026-02-12. Results received: No. Last updated: 2026-03-17.
Decision dates by country: ES: 2026-03-02, FR: 2026-02-16, IT: 2026-02-12

Condition(s): Narcolepsy and Idiopathic Hypersomnia
Product: ORX750, ORX750, ORX750, ORX750

Primary endpoint: Incidence, severity, and causal relationship of treatment emergent adverse events (TEAEs), including serious TEAEs, Changes from baseline in laboratory tests, including biochemistry, hematology, and urinalysis, Changes from baselinea in vital signs and weight, Changes from baseline in 12-lead electrocardiograms (ECGs), Columbia-Suicide Severity Rating Scale (C-SSRS) scores
Endpoint(s): PK: - Predose and post dose PK concentrations of ORX750 - Other PK parameters as appropriate, Efficacy: o Mean sleep latency (changes from baseline to Day 63) in the MWT (average of the first 4 trials) o Subjective daytime sleepiness (changes from baseline to specified post dose timepoints) using the ESS

Source: https://euclinicaltrials.eu/ctis-public/view/2025-522987-34-00